EU clinical trial 2023-504144-33-01: PERi-operative Selective Decontamination of the Digestive tract to prevent severe infectious complications after Esophagectomy: a Randomized multicenter clinical trial in patients with primary resectable esophageal carcinoma (cT1-4, N0-3, M0)
Protocol code: 114329
Sponsor: Stichting Radboud University Medical Center (Hospital/Clinic/Other health care facility). Phase: Phase III and phase IV (Integrated). Countries: Belgium (ongoing, recruiting), Netherlands (ongoing, recruiting).
Therapeutic area(s): Diseases [C] - Respiratory Tract Diseases [C08]; Diseases [C] - Digestive System Diseases [C06]; Diseases [C] - Bacterial Infections and Mycoses [C01]; Diseases [C] - Neoplasms [C04]
Gender: Female, Male. Age: 18-64 years, 65+ years. Enrolment: 853.
Status: Ongoing, recruiting. Start date (EU): 2024-10-17. Decision date: 2024-03-25. Results received: No. Last updated: 2026-04-14.
Decision dates by country: BE: 2024-03-25, NL: 2024-03-25

Condition(s): esophageal cancer
Product: Basis voor SDD suspensie, AMPHOTERICIN B, Nystatine Labaz, suspensie voor oraal gebruik 100.000 E/ml

Primary endpoint: the cumulative incidence of postoperative pneumonia within 30 days after surgery. (Pneumonia will be defined by the following criteria: - Positive sputum culture OR - Presence of a new progressive radiographic infiltrate plus at least 2 of the following clinical features: - Fever > 38.5°C - Leukocytosis (>11.0) or leukopenia (<4.0) - Purulent secretions)
Endpoint(s): the cumulative incidence of all postoperative infectious complications within 30 days as registered in DUCA (postoperative pneumonia, Clostridium difficile infection, urinary tract infection, wound infection/abscess requiring wound opening or antibiotic treatment, central line infection requiring line removal or antibiotic treatment, intra-thoracic/intra-abdominal abscess, generalised sepsis as defined by Evans, Rhodes (30), other infections requiring antibiotics, the cumulative incidence of anastomotic leakage within 30 days after esophagectomy for which endoscopic, radiologic, or surgical re-intervention is needed. This corresponds to the definition of the ECCG of anastomotic leakage type II and III Low, Alderson (32). Anastomotic leakage is defined by contrast leakage on CT-scan with intravenous and oral contrast (swallow CT-scan) upon clinical suspicion, by endoscopy or by drainage of ingested materials into the chest tube (thoracic anastomoses) or in, the all-cause mortality within 90 days after surgery, the rate of re-operation within 30 days after surgery, the postoperative length of stay on the intensive care unit (ICU), including re-admissions within 6 months after surgery, the postoperative length of the total hospital stay, including re-admissions for any reasons within 6 months after surgery, the quality of life (QoL) after 30 days, 3 months and 6 months after surgery (using internationally validated EORTC OG25, QLQC30 and EuroQoL-5D-5L questionnaires), Direct and indirect costs. The in-hospital and societal costs up to 6 months after surgery will be estimated with the help of the medical consumption questionnaire and the productivity cost questionnaire, developed by the iMTA

Source: https://euclinicaltrials.eu/ctis-public/view/2023-504144-33-01